EU clinical trial 2025-521164-36-00: A phase 1/2a, first-in-human, open-label, dose-escalating study with a safety expansion cohort to evaluate safety, tolerability, pharmacokinetics, pharmacodynamics and preliminary anti-tumour activity of TAX2 in patients with relapsed/refractory advanced/metastatic solid tumours
Protocol code: APM-CT001
Sponsor: Apmonia Therapeutics (Pharmaceutical company). Phase: Phase I and Phase II (Integrated)- First administration to humans. Countries: Belgium (authorised, recruitment pending), France (authorised, recruitment pending).
Therapeutic area(s): Diseases [C] - Neoplasms [C04]
Gender: Female, Male. Age: 18-64 years, 65+ years. Enrolment: 48.
Status: Authorised, recruitment pending. Decision date: 2026-02-19. Results received: No. Last updated: 2026-07-01.
Decision dates by country: BE: 2026-02-20, FR: 2026-02-19

Condition(s): Patients with relapsed/refractory advanced/metastatic ovarian cancer (aOC), metastatic colorectal cancer (mCRC), metastatic pancreatic cancer (mPC), or cutaneous metastatic melanoma (MM) who have exhausted all treatment options.

Primary endpoint: The primary endpoint for Phase 1 dose escalation is to determine the number of patients with DLTs., For Phase 2a safety expansion cohort, safety and tolerability at RP2D will be determined as primary endpoint on the frequency and number of patients with AEs.
Endpoint(s): Secondary dose escalation endpoints include safety and tolerability to be determined based on the frequency and number of patients with AEs (including treatment-emergent AEs [TEAEs] serious AEs [SAEs], AEs of special interest [AESIs] and clinically significant abnormal laboratory parameters) and the intensity of these AEs using the common terminology criteria for adverse events (CTCAE) version 6.0., Efficacy (preliminary anti-tumour activity) endpoints (both dose escalation and safety expansion): ORR, DCR, BOR, DOR, and PFS using tumour response assessment based on RECIST version 1.1, and OS, PK endpoints: Characterisation of the TAX2 PK profile (determination of Cmax, Ctrough, tmax, AUC0-last, AUC0-inf, t1/2; accumulation ratio Rac will be calculated based on Cmax and AUC0-last; dose proportionality [dose-escalation part only]), PD endpoints (both dose escalation and safety expansion): The TAX2 PD effects will be assessed based on markers related to anti-tumour effects (circulating and tissue markers of tumour response).

Source: https://euclinicaltrials.eu/ctis-public/view/2025-521164-36-00